EU clinical trial 2024-519770-38-00: Randomized Cross-Over Experimental Trial of Treatment with Sumatriptan vs. Rimegepant During Nitroglycerin (NTG)-Induced Headache in Patients with Episodic Migraine for the Determination of Molecular and Clinical Biomarkers (MAMBO II Study).
Protocol code: MAMBO-II
Sponsor: Fundacio Hospital Universitari Vall D’Hebron Institut De Recerca (Laboratory/Research/Testing facility). Phase: Therapeutic use (Phase IV). Countries: Spain (ongoing, recruiting).
Therapeutic area(s): Diseases [C] - Nervous System Diseases [C10]
Gender: Female, Male. Age: 18-64 years. Enrolment: 24.
Status: Ongoing, recruiting. Start date (EU): 2026-03-05. Decision date: 2025-04-01. Results received: No. Last updated: 2026-06-05.

Condition(s): Migraine
Product: GLYCERYL TRINITRATE, RIMEGEPANT, SUMATRIPTAN

Primary endpoint: Temporal evolution of GRP, AMY , VIP and PACAP-38 levels in blood (4 time points: Basal, begging migraine; peak-migraine; 2 hours post migraine treatment)

Source: https://euclinicaltrials.eu/ctis-public/view/2024-519770-38-00